EU clinical trial 2024-510792-38-01: Medical expulsive therapy using diuretics after shock wave lithotripsy of kidney stones, a randomised clinical trial.
Sponsor: Region Midtjylland (Hospital/Clinic/Other health care facility). Phase: Therapeutic confirmatory (Phase III). Countries: Denmark (not authorised).
Therapeutic area(s): Diseases [C] - Pathological Conditions, Signs and Symptoms [C23]
Gender: Female, Male. Age: 18-64 years. Enrolment: 420.
Status: Not authorised. Decision date: 2025-02-26. Results received: No. Last updated: 2025-02-26.

Condition(s): Medical expulsive therapy using diuretics and alpha-blockers after shock wave lithotripsy of kidney stones
Product: Furosemide 20mg Tablets., Tamsulosin Krka 0,4 mg Retardtabletten, Ibuprofen Bluefish 400 mg film-coated tablets, Paracetamol Orifarm 500 mg filmdragerade tabletter

Primary endpoint: • Stone clearance: A stone-free condition is defined as the complete absence of any stone or the presence of residual fragments smaller than 3 mm in diameter and should be evaluated 4 weeks after last treatment with Non-contrast CT.
Endpoint(s): Clinical outcomes and success as measured in terms of stone-free rate after ESWL is strongly correlated to pain experienced during and after the treatment. The secondary outcomes will be: • Compare pain during and post ESWL period using a validated VAS. Combination of the two types of medicine is going to be evaluated on the degree of the pain relief. The intensity of their pain will be assessed in three phases; • During the two sessions of ESWL and 2 weeks after the last procedure.

Source: https://euclinicaltrials.eu/ctis-public/view/2024-510792-38-01